EU clinical trial 2023-509392-17-00: International Study for Treatment of Childhood Relapsed Precursor B-Cell ALL 2020 - A Randomized Phase III Study Conducted by the Resistant Disease Committee of the International BFM Study Group - IntReALL BCP 2020
Protocol code: IntReALL BCP 2020
Sponsor: Charite Universitaetsmedizin Berlin KöR (Hospital/Clinic/Other health care facility). Phase: Therapeutic confirmatory (Phase III). Countries: Netherlands (authorised, recruitment pending), Czechia (authorised, recruitment pending), Italy (authorised, recruitment pending), Spain (authorised, recruitment pending), Denmark (authorised, recruitment pending), Austria (authorised, recruitment pending), Norway (authorised, recruitment pending), Sweden (authorised, recruitment pending), Germany (authorised, recruitment pending), France (authorised, recruitment pending), Finland (authorised, recruitment pending).
Therapeutic area(s): Diseases [C] - Hemic and Lymphatic Diseases [C15]; Diseases [C] - Neoplasms [C04]
Gender: Female, Male. Age: 0-17 years, 18-64 years. Enrolment: 765.
Status: Authorised, recruitment pending. Decision date: 2025-12-09. Results received: No. Last updated: 2026-04-13.
Decision dates by country: DE: 2025-12-15, FI: 2025-12-09, ES: 2025-12-11, CZ: 2025-12-09, FR: 2025-12-15, SE: 2025-12-12, IT: 2025-12-11, AT: 2025-12-14, NO: 2025-12-11, DK: 2025-12-09, NL: 2025-12-11

Condition(s): Relapsed Acute Lymphoblastic Leukemia (ALL)
Product: Etoposide 20 mg/ml Concentrate for Solution for Infusion, Vincristine Sulfate 1 mg/ml solution for injection, ELDISINE® 5 mg Pulver zur Herstellung einer Injektionslösung Vindesinsulfat, HOLOXAN 1000 mg Pulver zur Herstellung einer Injektionslösung, Cytarabin Accord 100 mg/ml Injektions-/Infusionslösung, Mercaptopurine 50mg tablets, BLINCYTO 38.5 micrograms powder for concentrate and solution for solution for infusion., INOTUZUMAB OZOGAMICIN, Cytarabine Accord Healthcare 20 mg/ml injektio-/infuusioneste, liuos, METHOTREXATE, METHOTREXATE, Metex 50 mg/ml injekcinis tirpalas užpildytame švirkšte, Mitoxantrone 2 mg/ml concentrate for solution for infusion, Thioguanin "Aspen" 40mg Tabletten, DEXAMETHASONE MEDISOL 8 mg/2 ml, solution injectable, Cyclophosphamid beta 500 mg/ml Konzentrat zur Herstellung einer Injektions-/Infusionslösung, Oncaspar 750 U/ml powder for solution for injection/infusion, Daunoblastin 20 mg Pulver zur Herstellung einer Infusions- oder Injektionslösung, Solu-Dacortin 250 mg Pulver und Lösungsmittel zur Herstellung einer Injektionslösung oder Infusionslösung, Zavedos® 5 mg Pulver und Lösungsmittel zur Herstellung einer Injektionslösung Wirkstoff: Idarubicinhydrochlorid

Primary endpoint: SR induction: Event-free survival (EFS), SR-MRD good response consolidation: DFS, HR with CR2 consolidation: DFS, IEM: EFS
Endpoint(s): SR induction: MRD negativity rate after induction, SR induction: Proportion of patients requiring allo-HSCT, SR induction: OS, SR induction: Toxicity (assessed by CTCAE grades and SAE reports), SR induction: Rate of patients with CD19 positive cells after SCB1 prior to Blinatumomab, SR-MRD good response consolidation: OS, SR-MRD good response consolidation: Toxicity (quantified by CTCAE grades and SAE reports), HR with CR2 consolidation: OS, HR with CR2 consolidation: MRD negativity rates before allo-HSCT, HR with CR2 consolidation: allo-HSCT rates, IEM: EFS by MRD at relapse diagnosis (cut-off 10-4), IEM: OS, IEM: DFS by MRD after induction (cut-off 10-4) in patients with BM MRD > 10e-4 at relapse, Serum pharmacokinetic parameters of InO (Cmax and Ctrough)

Source: https://euclinicaltrials.eu/ctis-public/view/2023-509392-17-00